EU clinical trial 2023-506838-68-00: A Phase 1b/2 Study of Immune and Targeted Combination Therapies in Participants with RCC (KEYMAKER-U03): Substudy 03A in First Line Metastatic Participants
Protocol code: MK-3475-03A
Sponsor: Merck Sharp & Dohme LLC (Pharmaceutical company). Phase: Phase I and Phase II (Integrated)- Other. Countries: Hungary (ended), Spain (ended), Netherlands (ended), Poland (ended), France (ended).
Therapeutic area(s): Diseases [C] - Neoplasms [C04]
Gender: Female, Male. Age: 18-64 years, 65+ years. Enrolment: 62.
Status: Ended. Start date (EU): 2020-12-10. End date (EU): 2026-08-06. Decision date: 2024-01-22. Results received: No. Last updated: 2026-06-25.
Decision dates by country: NL: 2024-01-22, HU: 2024-01-23, FR: 2024-05-27, PL: 2024-01-26, ES: 2024-01-29

Condition(s): Renal cell carcinoma
Product: KEYTRUDA 25 mg/mL concentrate for solution for infusion, MK-7684A, Belzutifan, Lenvatinib, Lenvatinib, MK-1308A, MK-4280A

Primary endpoint: afety Lead-in Phase: Number of participants who experience one or more dose-limiting toxicities (DLTs), Safety Lead-in Phase: Number of participants who experience one or more adverse events (AEs), Safety Lead-in Phase: Number of participants who discontinue study treatment due to an AE, Efficacy Phase: Number of participants who experience one or more DLTs, Efficacy Phase: Number of participants who experience one or more AEs, Efficacy Phase: Number of participants who discontinue study treatment due to an AE, Efficacy Phase: Objective response rate (ORR)
Endpoint(s): Efficacy Phase: Duration of response (DOR), Efficacy Phase: Progression-free survival (PFS), Efficacy Phase: Overall survival (OS), Efficacy Phase: Clinical benefit rate (CBR)

Source: https://euclinicaltrials.eu/ctis-public/view/2023-506838-68-00